EU clinical trial 2024-519288-17-00: Treatment of High-risk Non-muscle Invasive Bladder Cancer With IMUNO BGC Moreau RJ as Prophylaxis
Protocol code: ENCORE-01
Sponsor: Biofabri S.L., Fundacion Para La Investigacion En Urologia (Pharmaceutical company, Patient organisation/association). Phase: Therapeutic exploratory (Phase II). Countries: Spain (ongoing, recruitment ended).
Therapeutic area(s): Diseases [C] - Neoplasms [C04]
Gender: Female, Male. Age: 18-64 years, 65+ years. Enrolment: 306.
Status: Ongoing, recruitment ended. Start date (EU): 2019-04-26. Decision date: 2024-12-11. Results received: No. Last updated: 2026-04-30.

Condition(s): High-risk Non-muscle Invasive Bladder Cancer
Product: IMUNO BCG Moreau RJ

Primary endpoint: The effectiveness of the IMUNO BCG Moreau RJ strain will be assessed primarily by calculating the rate of progression at 24 months after the last transurethral resection (LTRU). The progression rate at 24 months is the proportion of patients who, after the last tumor resection and within a follow-up period of 24 months, undergo progression according to the TNM classification approved by the International Union Against Cancer in its 8th edition of 2017.
Endpoint(s): Progression rate at 12 months: proportion of patients, out of the total, who have been on treatment with the IMUNO BCG Moreau RJ strain and in whom the tumour has progressed within a 12-month follow-up period., Progression rate at 24 months: proportion of patients, out of the total, who have been on treatment with the IMUNO BCG Moreau RJ strain and in whom the tumour has progressed within a follow-up period of 24 months., Disease-free survival: tumour classification (TNM) from the date of first instillation (time zero) to recurrence or end of follow-up will be assessed., Quality of life: questionnaire published and validated in the scientific literature and adapted to Spanish, Functional Assessment of Cancer Therapy-Bladder Cancer (FACT-BL) v. 4., Adverse reactions (ARs): the description of ARs will be based on the MedDRA dictionary of the International Conference on Harmonisation of Technical Requirements for Registration of Pharmaceuticals for Human Use (ICH). The number and frequency of patients with AEs, their severity, as well as the distribution of all AEs will be described., Dropout rate due to toxicity: study withdrawals (number and percentage) due to the impossibility of continuing due to side effects will be evaluated, as well as those patients who have not discontinued., Immunological response: analysis of cytokines in urine prior to instillation at induction visits 1, 2, 5 and 6.

Source: https://euclinicaltrials.eu/ctis-public/view/2024-519288-17-00